EU clinical trial 2023-509607-32-00: Lithium versus Lamotrigine in bipolar disorder, type II – a single blinded randomized controlled trial (the LiLa-Bipolar RCT)
Sponsor: Region Hovedstaden, Frederiksberg Hospital (Hospital/Clinic/Other health care facility). Phase: Therapeutic use (Phase IV). Countries: Denmark (ongoing, recruiting).
Therapeutic area(s): Psychiatry and Psychology [F] - Mental Disorders [F03]
Gender: Female, Male. Age: 18-64 years, 65+ years. Enrolment: 200.
Status: Ongoing, recruiting. Start date (EU): 2024-04-29. Decision date: 2024-03-25. Results received: No. Last updated: 2026-03-10.

Condition(s): Bipolar Disorder, Type II
Product: Litiumkarbonat "OBA", filmovertrukne tabletter, Lamictal 25 mg tablete

Primary endpoint: Primary: Mood stabilization will be measured by a mood instability score reflecting the daily variability in self-monitored mood collected via the Monsenso system (see section 2.3.4 in Protocol).
Endpoint(s): Young mania rating scale, Hamilton Rating Scale for Depression (17 items), functional assessment short test, Internet-based Cognition Assessment Tool (ICAT), blood based inflammation markers collected in blood sample, hair cortisol level (see detailed description in section 4 in protocol).

Source: https://euclinicaltrials.eu/ctis-public/view/2023-509607-32-00